EU clinical trial 2024-517646-34-00: Determining the clinical relevance of the interaction between enzalutamide and the opioid morphine and the DOAC edoxaban to improve rational pharmacological care of patients with prostate cancer
Sponsor: Radboud universitair medisch centrum Stichting (Hospital/Clinic/Other health care facility). Phase: Therapeutic use (Phase IV). Countries: Netherlands (ended).
Therapeutic area(s): Diseases [C] - Neoplasms [C04]
Gender: Male. Age: 65+ years. Enrolment: 40.
Status: Ended. Start date (EU): 2023-02-01. End date (EU): 2025-07-15. Decision date: 2024-11-15. Results received: No. Last updated: 2024-11-15.

Condition(s): Prostate cancer
Product: MORPHINE, EDOXABAN, ENZALUTAMIDE

Primary endpoint: To determine the change in edoxaban and M4 exposure (AUC0-24hr) with or without enzalutamide - To determine the change in morphine and morphine-6- glucuronide exposure (AUC0-12hr) with or without enzalutamide
Endpoint(s): If a patient also has a treatment indication with opioids for pain: To evaluate the pain control (with the Numeric Rating Scale) in patients treated with and without enzalutamide and morphineTo evaluate the safety of the combination of enzalutamide with edoxaban and/or morphine monitored with CTC-AE v 5.0 criteria. - To evaluate the effect of edoxaban and/or morphine on enzalutamide exposure

Source: https://euclinicaltrials.eu/ctis-public/view/2024-517646-34-00